EU clinical trial 2023-505280-36-00: A PHASE 1, RANDOMIZED, DOUBLE-BLIND, PARALLEL AND PLACEBO-CONTROLLED SINGLE AND MULTIPLE ASCENDING DOSE TRIAL INVESTIGATING SAFETY, TOLERABILITY AND PHARMACOKINETICS OF LIB-01 IN HEALTHY PARTICIPANTS
Protocol code: DCT3934
Sponsor: Dicot AB (Pharmaceutical company). Phase: Human Pharmacology (Phase I)- First administration to humans. Countries: Sweden (ended).
Therapeutic area(s): Diseases [C] - Male Urogenital Diseases [C12]
Gender: Male. Age: 18-64 years, 65+ years. Enrolment: 72.
Status: Ended. Start date (EU): 2023-08-25. End date (EU): 2024-04-04. Decision date: 2023-08-14. Results received: No. Last updated: 2023-10-05.

Condition(s): Erectile dysfunction

Source: https://euclinicaltrials.eu/ctis-public/view/2023-505280-36-00